EU clinical trial 2023-509710-11-00: A Phase 2 Study Evaluating the Efficacy, Safety, Pharmacokinetics, and Pharmacodynamics of Narsoplimab in Paediatric Patients (28 Days to 18 Y.O.) with High-Risk Haematopoietic Stem Cell Transplant Thrombotic Microangiopathy
Protocol code: OMS721-HCT-002
Sponsor: Omeros Corp. (Pharmaceutical company). Phase: Therapeutic exploratory (Phase II). Countries: Netherlands (ongoing, recruiting), Spain (authorised, recruiting), Germany (ongoing, recruiting).
Therapeutic area(s): Diseases [C] - Immune System Diseases [C20]
Gender: Female, Male. Age: 0-17 years. Enrolment: 5.
Start date (EU): 2023-07-11. Decision date: 2024-06-06. Results received: No. Last updated: 2026-04-10.
Decision dates by country: ES: 2024-06-06, NL: 2024-06-07, DE: 2024-06-14

Condition(s): Haematopoietic Stem Cell Transplant Thrombotic Microangiopathy

Primary endpoint: 100-day survival rate from date of HSCT-TMA diagnosis
Endpoint(s): Survival at 52 weeks and median, mean, and overall survival from date of TMA diagnosis, Narsoplimab peak and trough PK and concomitant lectin pathway activation measured by ex vivo assay, Safety will be evaluated by adverse events and laboratory measures., Anti-drug antibody response, Responder rate based on clinical response criteria

Source: https://euclinicaltrials.eu/ctis-public/view/2023-509710-11-00